EU clinical trial 2023-503753-35-01: FIT-HF - Effect of weight loss on physical and cardiac performance in patients with heart failure and obesity
Protocol code: FIT-HF trial
Sponsor: Region Hovedstaden (Hospital/Clinic/Other health care facility). Phase: Therapeutic exploratory (Phase II). Countries: Denmark (ongoing, recruiting).
Therapeutic area(s): Diseases [C] - Nutritional and Metabolic Diseases [C18]; Diseases [C] - Cardiovascular Diseases [C14]
Gender: Female, Male. Age: 18-64 years, 65+ years. Enrolment: 100.
Status: Ongoing, recruiting. Start date (EU): 2024-03-20. Decision date: 2024-02-09. Results received: No. Last updated: 2025-08-22.

Condition(s): Obesity and Heart Failure with reduced Ejection Fracition
Product: Wegovy 0.25 mg solution for injection in pre-filled pen, Wegovy 0.5 mg solution for injection in pre-filled pen, Wegovy 1 mg solution for injection in pre-filled pen, Wegovy 1.7 mg solution for injection in pre-filled pen, Wegovy 2.4 mg solution for injection in pre-filled pen

Primary endpoint: The primary endpoint is change in peak oxygen uptake per kg per min (Vo2max) at 52 weeks between groups.
Endpoint(s): • To compare the effect of weight loss on quality of life assessed by the Kansas City Cardiomyopathy Questionnaire (KCCQ). • To compare the effect of weight loss on the 6MWD • To compare the effect of weight loss on the end-systolic volume assessed by Cardiac MR • To compare the effect of weight loss on the change in biomarkers as high-sensitivity CRP and pro-BNP • Feasibility and safety of a modern weight loss program for weight lowering in high-risk symptomatic patients.

Source: https://euclinicaltrials.eu/ctis-public/view/2023-503753-35-01